EU clinical trial 2024-512967-29-00: PaTH Forward: A Phase 2, Multicenter, Randomized, Double-Blind, Placebo Controlled, Parallel Group Trial with an Open-Label Extension, Investigating the Safety, Tolerability and Efficacy of TransCon PTH Administered Subcutaneously Daily in Adults with Hypoparathyroidism
Protocol code: TransCon PTH TCP-201
Sponsor: Ascendis Pharma Bone Diseases A/S (Pharmaceutical company). Phase: Therapeutic exploratory (Phase II). Countries: Denmark (ended), Germany (ended), Norway (ended), Italy (ended).
Therapeutic area(s): Diseases [C] - Hormonal diseases [C19]
Gender: Female, Male. Age: 18-64 years, 65+ years. Enrolment: 21.
Status: Ended. Start date (EU): 2019-09-03. End date (EU): 2025-03-21. End date: 2025-04-17. Decision date: 2024-07-30. Results received: Yes. Last updated: 2024-11-19.
Decision dates by country: DK: 2024-07-31, DE: 2024-08-01, IT: 2024-08-05, NO: 2024-07-30

Condition(s): Hypoparathyroidism (HP) in Adults
Product: TransCon PTH

Primary endpoint: At 4 weeks of treatment, the proportion of subjects with: • Albumin-adjusted sCa within the normal range and • Spot morning fractional excretion of calcium (spot AM FECa) within normal range (≤2%) or a reduction by at least 50% from baseline and • Not taking active vitamin D supplements and • Taking ≤1000 mg/day of calcium supplements
Endpoint(s): Key Secondary Efficacy Endpoint: At 4 weeks of treatment, the proportion of subjects with: • Albumin-adjusted sCa within the normal range and • FECa within the normal range or a reduction by at least 50% from baseline and • Not taking active vitamin D supplements and • Taking ≤500 mg/day of calcium supplements

Source: https://euclinicaltrials.eu/ctis-public/view/2024-512967-29-00